EU clinical trial 2024-512950-13-00: Beta-Lactam antibiotics initiaL expoSure optimisEd in criticallY ill patients with sEpsis (BuLLSEYE)
Sponsor: Erasmus Universitair Medisch Centrum Rotterdam (Erasmus MC) (Hospital/Clinic/Other health care facility). Phase: Phase III and phase IV (Integrated). Countries: Netherlands (ongoing, recruiting).
Therapeutic area(s): Diseases [C] - Bacterial Infections and Mycoses [C01]
Gender: Female, Male. Age: 18-64 years, 65+ years. Enrolment: 988.
Status: Ongoing, recruiting. Start date (EU): 2025-01-03. Decision date: 2024-09-30. Results received: No. Last updated: 2026-01-05.

Condition(s): Sepsis
Product: Ceftriaxon Fresenius Kabi 1 g poeder voor oplossing voor injectie of infusie, Ceftazidim Fresenius Kabi 500 mg poeder voor oplossing voor injectie, Amoxicilline/Clavulaanzuur Sandoz 2000 mg/200 mg i.v., poeder voor oplossing voor intraveneuze infusie, Cefuroxim Hikma 1500 mg poeder voor oplossing voor injectie of infusie, Meropenem CF 1000 mg, poeder voor oplossing voor injectie of infusie, Meropenem Fresenius Kabi 1 g poeder voor oplossing voor injectie of infusie, Piperacilline/Tazobactam Fresenius Kabi 2 g/0,25 g poeder voor oplossing voor infusie, Cefotaxim 1000 mg PCH, poeder voor oplossing voor injectie, Floxapen, poeder voor oplossing voor injectie 250 mg, 500 mg en 1 g, Amoxicilline CF 125 mg, poeder voor oplossing voor injectie of infusie Amoxicilline CF 250 mg, poeder voor oplossing voor injectie of infusie Amoxicilline CF 500 mg, poeder voor oplossing voor injectie of infusie Amoxicilline CF 1000 mg, poeder voor oplossing voor injectie of infusie

Primary endpoint: 28-day mortality
Endpoint(s): • Blood levels of antibiotics at 24, 48 and 72 hours after start therapy., • Infection parameters (CRP, procalcitonin, white blood cell count)., • 365-day mortality, • 90-day mortality, • Hospital length of stay, • ICU length of stay, Post study calculation of the costs in both study groups., EQ5D questionnaire 3 and 12 months after admission, Number of AEs, SAEs and SUSARs, Delta SOFA (T0- T3)

Source: https://euclinicaltrials.eu/ctis-public/view/2024-512950-13-00